EU clinical trial 2024-516156-18-00: Dual 64Cu-DOTATATE and 18F-FDG PET/CT Imaging of Patients with Neuroendocrine Neoplasms
Protocol code: AK_NEN_DOTA-FDG_21
Sponsor: Rigshospitalet (Hospital/Clinic/Other health care facility). Phase: Therapeutic exploratory (Phase II). Countries: Denmark (ongoing, recruiting).
Therapeutic area(s): Diseases [C] - Neoplasms [C04]
Gender: Female, Male. Age: 18-64 years, 65+ years. Enrolment: 200.
Status: Ongoing, recruiting. Start date (EU): 2023-01-17. Decision date: 2024-08-20. Results received: No. Last updated: 2024-08-20.

Condition(s): Neuroendocrine neoplasms
Product: 64CU-DOTATATE, Fluor-18-FDG, 400 MBq-210 GBq, injektionsvreske Fludeoxyglucose (18F)

Primary endpoint: Progression free survival (PFS).
Endpoint(s): Overall survival (OS), The proportion of patients who are considered eligible for peptide receptor radionuclide therapy based on their 64Cu-DOTATATE PET/CT scan, The correlation between standardized uptake values from tumors and healthy tissues derived from manually depicted regions-of-interests measured on 18FDG and 64Cu-DOTATATE

Source: https://euclinicaltrials.eu/ctis-public/view/2024-516156-18-00